EU clinical trial 2024-510913-13-00: A Randomized, Double-Blind Phase 2/3 Study of Relatlimab Combined with Nivolumab vs Nivolumab in Participants with Previously Untreated Metastatic or Unresectable Melanoma
Protocol code: CA224-047
Sponsor: Bristol-Myers Squibb Services Unlimited Company (Pharmaceutical company). Phase: Phase II and Phase III (Integrated). Countries: Romania (ongoing, recruitment ended), Finland (ongoing, recruitment ended), Austria (ongoing, recruitment ended), Italy (ongoing, recruitment ended), Germany (ongoing, recruitment ended), Belgium (ongoing, recruitment ended), France (ongoing, recruitment ended), Spain (ongoing, recruitment ended), Greece (ongoing, recruitment ended), Norway (ongoing, recruitment ended), Denmark (ongoing, recruitment ended), Sweden (ongoing, recruitment ended), Poland (ongoing, recruitment ended).
Therapeutic area(s): Diseases [C] - Neoplasms [C04]
Gender: Female, Male. Age: 0-17 years, 18-64 years, 65+ years. Enrolment: 340.
Status: Ongoing, recruitment ended. Start date (EU): 2018-05-18. Decision date: 2024-04-10. Results received: No. Last updated: 2026-08-06.
Decision dates by country: NO: 2024-04-10, DK: 2024-04-11, SE: 2024-04-11, BE: 2024-04-17, IT: 2024-04-15, ES: 2024-04-10, DE: 2024-04-15, RO: 2024-04-11, AT: 2024-04-15, PL: 2024-04-12, FI: 2024-04-11, FR: 2024-04-15, GR: 2024-05-24

Condition(s): Previously Untreated Metastatic or Unresectable Melanoma
Product: Nivolumab/Relatlimab, OPDIVO 10 mg/mL concentrate for solution for infusion.

Primary endpoint: Progression Free Survival (PFS) Phase 3 portion of trial. Assessed by a Blinded Independent Central Review (BICR), PFS Phase 2 portion of trial, assessed by a BICR
Endpoint(s): Phase 3 portion of trial: Overall Survival (OS), Phase 3 portion of trial: ORR , assessed by a BICR, Phase 2 portion of trial: ORR , assessed by a BICR. In the randomized population and in subgroups, Phase 2 portion of trial: Duration of Response (DOR) in the randomized population and in subgroups, Phase 2 portion of trial: PFS in subgroups, Phase 2 portion of trial: OS in the randomized population and in subgroups, Phase 2 portion of the trial: Number of Adverse Events (AEs), Phase 2 portion of the trial: Number of Serious Adverse Events (SAEs), Phase 2 portion of the trial: Number of AEs Leading to Discontinuation, Phase 2 portion of the trial: Number of Deaths, Phase 2 portion of the trial: Number of Laboratory Abnormalities

Source: https://euclinicaltrials.eu/ctis-public/view/2024-510913-13-00